EU clinical trial 2022-500338-27-00: CAT-Trial: CGRP monoclonal Antibody for Treatment of painful diabetic neuropathy: a double-blind, multicenter, placebo-controlled, international phase II clinical trial
Sponsor: Aarhus University Hospital (Hospital/Clinic/Other health care facility). Phase: Therapeutic exploratory (Phase II). Countries: Denmark (ended).
Therapeutic area(s): Diseases [C] - Nervous System Diseases [C10]
Gender: Female, Male. Age: 18-64 years, 65+ years. Enrolment: 95.
Status: Ended. Start date (EU): 2023-09-14. End date (EU): 2026-07-16. Decision date: 2023-02-27. Results received: No. Last updated: 2025-07-08.

Condition(s): Painful diabetic polyneuropathy
Product: VYEPTI 100 mg concentrate for solution for infusion, Saline Nebuliser Solution (Sodium Chloride 0.9% w/v)

Primary endpoint: Difference in self-reported average pain intensity between eptinezumab treated group and placebo treated group by the average numerical rating scale (NRS) (0-10) using a modified version of the BPI from baseline (1 week before randomization) over 24 weeks after first administration.
Endpoint(s): Difference between groups in neuropathic pain severity as measured by Neuropathic Pain Scale (NPS) at baseline, weeks 12 and 24, Difference in pain relief (complete, good, moderate, mild, none, worse) at weeks 12 and 24

Source: https://euclinicaltrials.eu/ctis-public/view/2022-500338-27-00